EU clinical trial 2025-521325-33-00: A 26-Week (with 26 Week Extension) Randomized, Multi-Center, Double-Blind Phase 2 Study to Evaluate the Efficacy and Safety of XC001 Gene Therapy as an Adjunct to Coronary Artery Bypass Graft Surgery for Patients with Symptomatic Coronary Artery Disease with Left Ventricular Dysfunction at Risk for Incomplete Revascularization
Protocol code: XC001-1003
Sponsor: Xylocor Therapeutics Inc. (Pharmaceutical company). Phase: Therapeutic exploratory (Phase II). Countries: Netherlands (ended), Germany (ended), Hungary (ended), Poland (ended).
Therapeutic area(s): Diseases [C] - Cardiovascular Diseases [C14]
Gender: Female, Male. Age: 18-64 years, 65+ years. Enrolment: 90.
Status: Ended. Start date (EU): 2026-03-18. End date (EU): 2026-03-30. End date: 2026-03-30. Decision date: 2025-11-11. Results received: Yes. Last updated: 2025-11-15.
Decision dates by country: DE: 2025-11-11, HU: 2025-11-12, NL: 2025-11-13, PL: 2025-11-15

Condition(s): Chronic angina and left ventricular dysfunction due to coronary artery disease that is considered high risk for incomplete revascularization via coronary artery bypass grafting
Product: Diluent A195, GADOBUTROL, ADENOSINE, REGADENOSON, XC001

Primary endpoint: Change from Baseline (post-CABG at Day 4-6) in treated segment(s) comparing XC001 and placebo in CMR imaging parameters at Weeks 12 and 26 post-surgery. The endpoint at the participant level is the proportion of qualifying segments that improve at 12 and/or 26 weeks as determined by myocardial ischemic burden (see details in the Protocol).
Endpoint(s): Change from Baseline (post-CABG at Day 4-6) in treated segment(s) comparing XC001 and placebo in CMR parameters at 12 and 26 weeks, as well as at 52 weeks (during the extension period) (unless stated otherwise). Baseline CMR is defined as CMR analysis at Day 4-6 post-CABG (see details regarding CMR parameters in the Protocol).

Source: https://euclinicaltrials.eu/ctis-public/view/2025-521325-33-00